EU clinical trial 2023-509138-21-00: An Open-Label Long-term Follow-up Study to Evaluate the Effects of Sotatercept When Added to Background Pulmonary Arterial Hypertension (PAH) Therapy for the Treatment of PAH (MK-7962-004)
Protocol code: A011-12
Sponsor: Acceleron Pharma Inc. (Pharmaceutical company). Phase: Therapeutic confirmatory (Phase III). Countries: Poland (ended), Belgium (ended), Sweden (ended), France (ended), Portugal (ended), Netherlands (ended), Croatia (ended), Denmark (ended), Italy (ended), Germany (ended), Czechia (ended), Greece (ended), Spain (ended), Austria (ended).
Therapeutic area(s): Diseases [C] - Cardiovascular Diseases [C14]
Gender: Female, Male. Age: 18-64 years, 65+ years. Enrolment: 420.
Status: Ended. Start date (EU): 2021-08-26. End date (EU): 2026-07-10. Decision date: 2024-09-24. Results received: No. Last updated: 2026-06-26.
Decision dates by country: AT: 2024-11-12, BE: 2024-09-26, CZ: 2024-11-21, ES: 2024-10-08, FR: 2024-09-26, SE: 2024-09-25, IT: 2024-10-09, GR: 2024-10-11, HR: 2024-09-25, NL: 2024-09-24, PL: 2024-09-25, DK: 2024-09-27, PT: 2024-09-27, DE: 2024-10-07

Condition(s): Pulmonary Arterial Hypertension (PAH)
Product: sotatercept, sotatercept

Primary endpoint: • Adverse events (AEs) • Anti-drug antibodies (ADA) • Clinical laboratory assessments (hematology) • Vital signs • 12-lead electrocardiogram (ECG)
Endpoint(s): • 6-minute walk distance (6MWD) • N-terminal pro-hormone B-type natriuretic peptide • World Health Organization (WHO) functional class • Pulmonary vascular resistance • Simplified French Risk score

Source: https://euclinicaltrials.eu/ctis-public/view/2023-509138-21-00